EU clinical trial 2024-513463-96-01: Assessment of the exposure-dependent perpetrator characteristics of metamizole on metabolic pathways and the pharmacokinetics of imatinib in healthy volunteers
Protocol code: K831
Sponsor: Universitaetsklinikum Heidelberg AöR (Hospital/Clinic/Other health care facility). Phase: Human Pharmacology (Phase I)- Other. Countries: Germany (ended).
Therapeutic area(s): Phenomena and Processes [G] - Metabolism [G03]; Phenomena and Processes [G] - Biological Phenomena [G16]
Gender: Female, Male. Age: 18-64 years. Enrolment: 36.
Status: Ended. Start date (EU): 2024-09-11. End date (EU): 2026-03-03. Decision date: 2024-09-02. Results received: No. Last updated: 2025-05-19.

Condition(s): Pharmacokinetic trial in healthy volunteers

Source: https://euclinicaltrials.eu/ctis-public/view/2024-513463-96-01